EU clinical trial 2024-518822-33-01: Intrathecal baclofen pump versus selective dorsal rhizotomy for non-ambulatory children with cerebral palsy
Protocol code: S67558
Sponsor: UZ Leuven (Hospital/Clinic/Other health care facility). Phase: Therapeutic use (Phase IV). Countries: Netherlands (authorised, recruitment pending), Belgium (authorised, recruitment pending).
Therapeutic area(s): Diseases [C] - Nervous System Diseases [C10]
Gender: Female, Male. Age: 0-17 years. Enrolment: 48.
Status: Authorised, recruitment pending. Decision date: 2026-01-27. Results received: No. Last updated: 2026-04-03.
Decision dates by country: NL: 2026-01-27, BE: 2026-04-03

Condition(s): Cerebral Palsy
Product: Baclofen Aguettant 2 mg/mL solution for infusion, Lioresal® Intrathecal Infusion 10mg/20ml, Lioresal® Intrathecal Infusion 10mg/5ml

Primary endpoint: Change in CP-CHILD caregiver version (in absolute value) in the first year postoperatively vs. immediately preoperatively (non-inferiority margin = clinically meaningful difference = 5/100).
Endpoint(s): Key secondary endpoints: Adverse events; cost-effectiveness and cost-utility. Additional secondary endpoints: Spasticity; range of motion; trunk control; communication; orobulbar function; sleep; urinary symptoms; spinal/hip deformities; medication use; quality of life; treatment goals; parental distress; patient satisfaction; healthcare costs; complications.

Source: https://euclinicaltrials.eu/ctis-public/view/2024-518822-33-01